EU clinical trial 2025-523997-18-00: Phase 1b/2 Study Evaluating the Efficacy and Safety of Risvutatug Rezetecan in Participants With Previously Treated Unresectable Advanced or Metastatic Sarcomas
Protocol code: 300640
Sponsor: Glaxosmithkline Research & Development Limited (Pharmaceutical company). Phase: Phase I and Phase II (Integrated)- Other. Countries: France (ongoing, recruiting).
Therapeutic area(s): Diseases [C] - Neoplasms [C04]
Gender: Female, Male. Age: 0-17 years, 18-64 years. Enrolment: 14.
Status: Ongoing, recruiting. Start date (EU): 2026-06-29. Decision date: 2026-05-27. Results received: No. Last updated: 2026-07-27.

Condition(s): Sarcoma

Primary endpoint: Progression free survival rate at week18 (PFS18) assessed by the investigator as per RECIST 1.1., Confirmed ORR, defined as the proportion of participants who have achieved a confirmed CR or PR as assessed by investigator, according to RECIST 1.1

Source: https://euclinicaltrials.eu/ctis-public/view/2025-523997-18-00